EU clinical trial 2024-514931-63-00: TGD001 SAD study in healthy volunteers
Sponsor: TargED Biopharmaceuticals B.V. (Pharmaceutical company). Phase: Human Pharmacology (Phase I)- First administration to humans. Countries: Germany (ended).
Therapeutic area(s): Diseases [C] - Cardiovascular Diseases [C14]
Gender: Male. Age: 18-64 years. Enrolment: 0.
Status: Ended. Start date (EU): 2025-03-14. End date (EU): 2025-07-22. Decision date: 2024-11-13. Results received: No. Last updated: 2025-07-22.

Condition(s): A Phase I randomized, double-blind, placebo-controlled study to assess the safety and pharmacokinetics of single-ascending doses of TGD001 in healthy volunteers

Source: https://euclinicaltrials.eu/ctis-public/view/2024-514931-63-00